EU clinical trial 2026-525242-29-00: A Phase III, Multicentre, Randomised, Double-Blind, Placebo-Controlled Study to Evaluate the Efficacy and Safety of Elafibranor in Adult Participants with Primary Sclerosing Cholangitis
Protocol code: CLIN-60190-475
Sponsor: Ipsen Bioscience Inc. (Pharmaceutical company). Phase: Therapeutic confirmatory (Phase III). Countries: Spain (authorised, recruitment pending), Sweden (authorised, recruitment pending), Germany (authorised, recruitment pending), Romania (authorised, recruitment pending), Finland (authorised, recruitment pending), Portugal (authorised, recruitment pending), Austria (authorised, recruitment pending), Italy (authorised, recruitment pending), Denmark (authorised, recruitment pending), Czechia (authorised, recruitment pending), France (authorised, recruitment pending), Netherlands (authorised, recruitment pending), Poland (authorised, recruitment pending), Belgium (authorised, recruitment pending), Norway (authorised, recruitment pending).
Therapeutic area(s): Diseases [C] - Digestive System Diseases [C06]
Gender: Female, Male. Age: 18-64 years, 65+ years. Enrolment: 127.
Status: Authorised, recruitment pending. Decision date: 2026-07-21. Results received: No. Last updated: 2026-08-07.
Decision dates by country: PL: 2026-07-23, AT: 2026-07-21, BE: 2026-07-23, CZ: 2026-07-22, DK: 2026-08-01, FI: 2026-07-22, FR: 2026-07-30, DE: 2026-07-23, IT: 2026-07-27, PT: 2026-07-28, RO: 2026-08-04, ES: 2026-07-27, SE: 2026-07-22, NL: 2026-07-22, NO: 2026-07-23

Condition(s): Primary Sclerosing Cholangitis
Product: elafibranor, Otherwise identical to the IMP

Primary endpoint: 1. Event-free survival, defined as the time from randomisation to the first occurrence of any of the following adjudicated clinical outcome events: • All-cause mortality • Liver transplantation • Hepatic decompensation, • Portal hypertension syndromes: • Cholangiopathy-related events:

Source: https://euclinicaltrials.eu/ctis-public/view/2026-525242-29-00